EU clinical trial 2024-514351-14-00: ErythroSIM : Randomized prospective trial evaluating the efficacy of the antiCD38 monoclonal antibody isatuximab in the treatment of PCRA by major ABO mismatch after allogeneic hematopoietic stem cell transplantation
Protocol code: APHP200067
Sponsor: Assistance Publique Hopitaux De Paris (Hospital/Clinic/Other health care facility). Phase: Therapeutic exploratory (Phase II). Countries: France (ongoing, recruiting).
Therapeutic area(s): Diseases [C] - Hemic and Lymphatic Diseases [C15]
Gender: Female, Male. Age: 0-17 years, 18-64 years, 65+ years. Enrolment: 90.
Status: Ongoing, recruiting. Start date (EU): 2023-02-20. Decision date: 2024-08-13. Results received: No. Last updated: 2026-02-25.

Condition(s): Pure cell red aplasia by major ABO mismatch after allogeneic hematopoietic stem cell transplantation
Product: SARCLISA 20mg/mL concentrate for solution for infusion.

Primary endpoint: Time to obtention of transfusion independence for patients with PRCA: time interval between randomization (corresponding to the M6 post-transplant) and resolution of PRCA (date of resolution of reticulocytopenia) treated or not by the anti-CD 38 monoclonal antibody isatuximab
Endpoint(s): -Number of red blood cell transfusions after randomization -Ferritin levels at M6, M9 and M15 post-transplant -Adverse events (CTC-AE grade ≥ 2) after randomization -Quality of life questionnaire (EORTC QLQ-C30- v3) at D60, D100, M6, M9, M12, M15 post-transplant, Factors associated with spontaneous resolution of PRCA between D60 and M6 post-transplant, - Antibody level (anti A and/or anti B titers) at D60, D100, M6 post-transplant then at each visit d15, d29, d45, and M3, M6, M9 post randomization,, - Number of days of hospitalization, transfusions support and chelation treatments

Source: https://euclinicaltrials.eu/ctis-public/view/2024-514351-14-00